EU clinical trial 2022-500176-63-00: Fentanyl or esketamine for traumatic pain trial
Protocol code: FP-2023
Sponsor: Amsterdam UMC (Hospital/Clinic/Other health care facility). Phase: Therapeutic confirmatory (Phase III). Countries: Netherlands (ongoing, recruitment ended).
Therapeutic area(s): Not possible to specify
Gender: Female, Male. Age: 18-64 years, 65+ years. Enrolment: 447.
Status: Ongoing, recruitment ended. Start date (EU): 2025-05-20. Decision date: 2023-08-29. Results received: No. Last updated: 2025-08-29.

Condition(s): Acute traumatic pain
Product: Natriumchloride 0,9% oplossing voor injectie, Fentanyl hameln 50 microgram/ml, oplossing voor injectie, Paracetamol Sanias 500 mg, tabletten, Esketiv 25 mg/ml, oplossing voor injectie, ESKETAMINE, Diclofenacnatrium Aurobindo 50 mg, maagsapresistente tabletten., Diclofenac Na CF 25 mg/ml, oplossing voor injectie, Paracetamol B. Braun 10 mg/ml, oplossing voor infusie, SODIUM CHLORIDE, FENTANYL CITRATE, Midazolam Aurobindo 5 mg/ml, oplossing voor injectie/infusie of rectale toediening

Primary endpoint: Difference in NRS score between baseline and 10 minutes after administration of study medication
Endpoint(s): Difference in NRS score between baseline and 20 minutes after first dose of study medication, Difference in NRS score between baseline and arrival at the hospital, Relative change in NRS score between baseline and 10 minutes after first dose of study medication, Relative change in NRS score between baseline and 20 minutes after first dose of study medication, Relative change in NRS score between baseline and arrival at the hospital, Number of subjects requiring a second dose of study medication, Number of subjects requiring unblinding because of treatment failure, Number of subjects experiencing adverse events, need for unblinding or intervention, Patient satisfaction with prehospital analgesia

Source: https://euclinicaltrials.eu/ctis-public/view/2022-500176-63-00